EU clinical trial 2023-508251-39-00: A prospective, randomized, controlled, open label, assessor-blinded, parallel-group Phase III clinical trial to evaluate the impact of tapering systemic immunosuppressive therapy in a treat-to-target approach on maintaining minimal disease activity in adult subjects with psoriatic arthritis
Protocol code: UKER-ATTRACTOR-01
Sponsor: Universitaetsklinikum Erlangen AöR (Hospital/Clinic/Other health care facility). Phase: Therapeutic confirmatory (Phase III). Countries: Germany (ongoing, recruiting), Italy (authorised, recruitment pending).
Therapeutic area(s): Diseases [C] - Immune System Diseases [C20]
Gender: Female, Male. Age: 18-64 years, 65+ years. Enrolment: 370.
Start date (EU): 2020-09-18. Decision date: 2023-10-04. Results received: No. Last updated: 2026-01-20.
Decision dates by country: DE: 2023-10-04, IT: 2024-07-24

Condition(s): Psoriatic arthritis
Product: SULFASALAZINE, Cimzia 200 mg solution for injection in pre-filled syringe, ADALIMUMAB, STELARA 45 mg solution for injection, Otezla 30 mg film-coated tablets, Tremfya 100 mg solution for injection in pre-filled pen., INFLIXIMAB, XELJANZ 5 mg film-coated tablets, Cimzia 200 mg solution for injection in dose-dispenser cartridge, LEFLUNOMIDE, Cosentyx 150 mg solution for injection in pre-filled pen, ORENCIA 125 mg solution for injection in pre-filled pen, XELJANZ 11 mg prolonged-release tablets, PREDNISOLONE, METHOTREXATE DISODIUM, ETANERCEPT, METHOTREXATE DISODIUM, ORENCIA 125 mg solution for injection in pre-filled syringe, Cimzia 200 mg solution for injection in pre-filled pen, ORENCIA 250 mg powder for concentrate for solution for infusion, Taltz 80 mg solution for injection in pre-filled pen, Cosentyx 150 mg solution for injection in pre-filled syringe, Skyrizi 150 mg solution for injection in pre-filled syringe, RINVOQ 15 mg prolonged-release tablets, Simponi 50 mg solution for injection in pre-filled syringe.

Primary endpoint: Presence of minimal disease activity (MDA ) 12 months after baseline., Mean PASDAS at month-12.
Endpoint(s): Key secondary endpoints: PASDAS, DAPSA and mCPDAI, Number of swollen and tender joints, Number of tender entheseal points (SPARCC, LEI, MASES entheseal point counts), Dactylitis counts, Activity of psoriasis (PASI, BSA), Activity of axial involvement (BASDAI), Quality of life and health/disability (PsAID-12, HAQ-DI, DLQI, ASQoL, SF-36), Pain (VAS), Proportion of patients with loss of MDA within 12 months after baseline, Proportion of patients with loss of MDA within 24 months after baseline, Time to loss of MDA, Time needed to restore MDA after readjustment of the DMARD therapy in subjects who lost MDA within the intervention period, Biomarker levels, Intervention-related events within the observation period of 24 months after baseline, AE, AR, SAE, SAR, SUSAR, Subjective (SACRAH, DASH, MHQshort) and objective (grip strength (lbf) and moberg-pick up test (s) hand function

Source: https://euclinicaltrials.eu/ctis-public/view/2023-508251-39-00